EU clinical trial 2022-501808-96-00: Venetoclax in combination with the BTK inhibitor Ibrutinib and Rituximab or conventional chemotherapy (Bendamustine) and Ibrutinib and Rituximab in patients with treatment naive Mantle Cell Lymphoma not eligible for high dose therapy
Protocol code: 20-01434
Sponsor: Universitatsmedizin der Johannes Gutenberg-Universitat Mainz KöR (Hospital/Clinic/Other health care facility). Phase: Therapeutic exploratory (Phase II). Countries: Germany (ongoing, recruiting), Italy (ongoing, recruiting).
Therapeutic area(s): Diseases [C] - Neoplasms [C04]
Gender: Female, Male. Age: 18-64 years, 65+ years. Enrolment: 235.
Status: Ongoing, recruiting. Start date (EU): 2023-05-15. Decision date: 2023-11-07. Results received: No. Last updated: 2026-07-29.
Decision dates by country: DE: 2023-11-07, IT: 2024-08-01

Condition(s): Mantle Cell Lymphoma
Product: Venetoclax, BENDAMUSTINE, Venetoclax, IMBRUVICA 140 mg hard capsules, RITUXIMAB, Venetoclax

Primary endpoint: To evaluate efficacy in both treatment arms: Failure-Free Survival (FFS) at 30 months
Endpoint(s): Failure-free survival (continuous observation), Progression-free survival, Complete Remission rate (CR) and overall response rate (ORR: CR, PR) four weeks after the end of induction therapy, best response, time to best response, time to first response, overall survival, Overall survival of patients divided according to the geriatric categories and treatment received, Safety: adverse events, tolerability, Quality of life during induction and maintenance therapy (assessed using the EORTC QLQ-C30 and the EORTC QLQ-NHL-HG29), Molecular remission after induction and conversion during maintenance (exploratory), Immune reconstitution, e.g. persistence of anti-Covid19 immunity, safety and efficacy in different geriatric categories

Source: https://euclinicaltrials.eu/ctis-public/view/2022-501808-96-00